EU clinical trial 2024-513738-39-00: A Phase 1b/2, multicenter study of vorasidenib in combination with temozolomide (TMZ) in participants with IDH1- or IDH2-mutant glioma
Protocol code: S095032-211
Sponsor: Institut De Recherches Internationales Servier IRIS (Pharmaceutical company). Phase: Phase I and Phase II (Integrated)- Other. Countries: Netherlands (ongoing, recruitment ended), Germany (ongoing, recruitment ended), France (ongoing, recruitment ended), Austria (ended), Spain (ongoing, recruitment ended), Italy (ongoing, recruitment ended).
Therapeutic area(s): Diseases [C] - Neoplasms [C04]
Gender: Female, Male. Age: 18-64 years, 65+ years. Enrolment: 17.
Start date (EU): 2025-03-18. Decision date: 2025-02-24. Results received: No. Last updated: 2025-12-18.
Decision dates by country: NL: 2025-02-24, FR: 2025-02-25, IT: 2025-03-21, DE: 2025-02-25, ES: 2025-02-28, AT: 2025-02-28

Condition(s): IDH1-mutant Glioma, IDH2-mutant Glioma
Product: Temozolomide Accord 5 mg hard capsules., Temozolomide ratiopharm 20 mg, capsules, hard, Temozolomide ratiopharm 250 mg, capsules, hard, Temozolomide SUN 100 mg hard capsules, Temozolomide SUN 180 mg hard capsules, Temozolomide Accord 140 mg hard capsules., TEMOZOLOMIDE VIATRIS 180 mg, gélule, Temozolomide ratiopharm 180 mg, capsules, hard, Temozolomide SUN 5 mg hard capsules, TEMOZOLOMIDE VIATRIS 140 mg, gélule, Temozolomide Accord 20 mg hard capsules, Temozolomide Accord 180 mg hard capsules., S95032/AG-881, TEMOZOLOMIDE VIATRIS 250 mg, gélule, Temozolomide ratiopharm 100 mg, capsules, hard, Temozolomide ratiopharm 5 mg, capsules, hard, Temozolomide SUN 20 mg hard capsules, Temozolomide SUN 140 mg hard capsules, Temozolomide ratiopharm 140 mg, capsules, hard, Temozolomide Accord 250 mg hard capsules., TEMOZOLOMIDE VIATRIS 5 mg, gélule, Temozolomide SUN 250 mg hard capsules, Temozolomide Accord 100 mg hard capsules., TEMOZOLOMIDE VIATRIS 20 mg, gélule, TEMOZOLOMIDE VIATRIS 100 mg, gélule

Primary endpoint: DLTs (for Phase 1b only), incidence and severity of AEs, SAEs, and AESIs, Progression-free Survival (PFS) status at 12 months
Endpoint(s): PFS, OS, OR, and clinical benefit (CR+ PR+SD), Plasma concentrations and PK parameters of vorasidenib and its metabolite AGI-69460 and TMZ

Source: https://euclinicaltrials.eu/ctis-public/view/2024-513738-39-00